EU clinical trial 2024-518457-42-00: A Phase II randomised, double-blind, parallel-group, multicentre, international trial to investigate the safety and efficacy of vicadrostat and empagliflozin administered with simultaneous vs staggered initiation in participants with chronic kidney disease at risk of kidney disease progression
Protocol code: 1378-0023
Sponsor: Boehringer Ingelheim International GmbH, Boehringer Ingelheim Espana S.A. (Pharmaceutical company). Phase: Therapeutic exploratory (Phase II). Countries: Italy (ended), Czechia (ended), Poland (ended), Spain (ended), France (ended), Germany (ended), Belgium (ended), Netherlands (ended).
Therapeutic area(s): Diseases [C] - Nutritional and Metabolic Diseases [C18]
Gender: Female, Male. Age: 18-64 years, 65+ years. Enrolment: 100.
Status: Ended. Start date (EU): 2025-08-28. End date (EU): 2026-07-11. Decision date: 2025-08-04. Results received: No. Last updated: 2026-03-13.
Decision dates by country: ES: 2025-08-08, BE: 2025-08-05, CZ: 2025-08-05, FR: 2025-08-04, DE: 2025-08-05, IT: 2025-08-07, NL: 2025-08-05, PL: 2025-08-11

Condition(s): chronic kidney disease
Product: BI 690517, Jardiance 10 mg film-coated tablets, Placebo matching vicadrostat

Primary endpoint: Absolute change in eGFR (mL/min/1.73m2) from baseline to Week 14 and week 16
Endpoint(s): Absolute change in eGFR (mL/min/1.73m2) from baseline to Week 12, Absolute change in SBP (mmHg) from baseline to Week 12, Relative change (ratio) in UACR from baseline to Week 6, Absolute change in serum potassium (mmol/L) from baseline to Week 12

Source: https://euclinicaltrials.eu/ctis-public/view/2024-518457-42-00